EU clinical trial 2023-510558-18-00: Randomized Phase 2 trial of induction treatment of anti-PD-1 pucotenlimab and EGFR-ADC MRG003 or EGFR-ADC alone followed by chemoradiotherapy in locally advanced head and neck squamous cell carcinoma (LA-SCCHN).
Protocol code: GORTEC 2024-03
Sponsor: Groupe Oncologie Radiotherapie Tete Cou (Patient organisation/association). Phase: Therapeutic exploratory (Phase II). Countries: France (ongoing, recruiting).
Therapeutic area(s): Diseases [C] - Neoplasms [C04]
Gender: Female, Male. Age: 18-64 years, 65+ years. Enrolment: 106.
Status: Ongoing, recruiting. Start date (EU): 2025-10-13. Decision date: 2025-06-24. Results received: No. Last updated: 2025-06-24.

Condition(s): locally advanced head and neck squamous cell carcinoma
Product: HX008, MRG003

Primary endpoint: Best objective response rate evaluated by the investigators with head and neck radiological imaging according to RECIST version 1.1 criteria at the end of induction phase of EGFR-ADC MRG003 + anti-PD-1 Pucotenlimab or EGFR-ADC MRG003 alone (21 ± 7 days after the Day 1 of last cycle of induction treatment). Objective response (OR) includes complete and partial response
Endpoint(s): • Progression-free survival (PFS) as the time from randomization to the first progression (locoregional/metastatic progression after induction, CRT or adjuvant treatment) or death from any cause, or the date of the last follow-up for patients who did not have progression or death., • Failure-free survival (FFS) as the time from randomization to the first of the following events: locoregional /metastatic progression after the completion of CRT or failure to receive CRT; or death from any cause or the date of the last follow-up for patients who did not have these events., • Overall survival (OS) defined as the time between randomization and death from any cause or date of the last follow-up for patients alive., • Compliance: for radiotherapy, total tumor dose, total number of fractions, total duration and major deviations will be reported and for anti-PD-1 + EGFR-ADC and cisplatin, number of cycles/injection, total dose, total duration of the treatment and dose intensity, and relative dose intensity (i.e. ratio of the dose received by the planned total dose). Whatever the treatment, treatment interruption, reduction and discontinuation and their reasons will be reported., • Incidence and severity of adverse events, serious adverse events and laboratory abnormalities as graded by the National Cancer Institute - Common Terminology Criteria of Adverse Events (NCI-CTCAE) v 5.0 from the randomization to one month after the end of the adjuvant treatment

Source: https://euclinicaltrials.eu/ctis-public/view/2023-510558-18-00